EU clinical trial 2024-511534-12-00: A Phase I/IIa, Open-label, Multi-center Study to Assess the Safety, Tolerability, Pharmacokinetics and Preliminary Efficacy of the ATR Kinase Inhibitor ART0380 Administered Orally as Monotherapy and in Combination to Patients with Advanced or Metastatic Solid Tumors
Protocol code: ART0380C001
Sponsor: Artios Pharma Limited (Pharmaceutical company). Phase: Phase I and Phase II (Integrated)- First administration to humans. Countries: France (ongoing, recruiting), Spain (ongoing, recruiting).
Therapeutic area(s): Diseases [C] - Neoplasms [C04]
Gender: Female, Male. Age: 18-64 years, 65+ years. Enrolment: 140.
Status: Ongoing, recruiting. Start date (EU): 2025-06-10. Decision date: 2024-10-28. Results received: No. Last updated: 2026-03-17.
Decision dates by country: ES: 2024-10-28, FR: 2024-10-30

Condition(s): Advanced or Metastatic Solid Tumours
Product: ART0380, ART0380, GEMCITABINE, ART0380, IRINOTECAN, ART0380

Primary endpoint: Part A: Incidence of dose-limiting toxicities (DLTs), Parts B1/B3/B4: Incidence and severity of AEs (CTCAE v5.0), Part B2: Progression free survival (RECIST v1.1), Part B5/B6: Objective Response Rate
Endpoint(s): Parts A/B1/B3/B4/B5/B6: Duration of Response, Best Overall Response, Objective Response Rate, Progression Free Survival, Overall Survival, Part B2 Incidence and severity of AEs, ART0380 Plasma concentration data., ART0380 renal clearance data, Part B2: Objective Response Rate, Duration of Response (based on RECIST v1.1)., Archival tumor or pre-dose tumor biopsy: Correlation of lesions in (or indicative of lesions in) DNA repair pathways, Plasma concentration data • Single dose PK parameters of ART0380 administered in fasting and fed states

Source: https://euclinicaltrials.eu/ctis-public/view/2024-511534-12-00